EU clinical trial 2022-502578-18-00: A Phase 3b/4 Randomized, Double-Blind, Double-Dummy, Active-Comparator Controlled Study, Comparing the Efficacy and Safety of Upadacitinib Versus Adalimumab in Subjects with Moderate to Severe Rheumatoid Arthritis on a stable background of MTX and who had an Inadequate Response or Intolerance to a Single TNF Inhibitor (SELECT- SWITCH)
Protocol code: M23-700
Sponsor: Abbvie Deutschland GmbH & Co. KG (Pharmaceutical company). Phase: Phase III and phase IV (Integrated). Countries: Greece (ended), Italy (ended), Portugal (ended), Germany (ended), Belgium (ended), France (ended), Romania (ended), Croatia (ended), Bulgaria (ended), Hungary (ended), Spain (ended).
Therapeutic area(s): Diseases [C] - Immune System Diseases [C20]
Gender: Female, Male. Age: 18-64 years, 65+ years. Enrolment: 148.
Status: Ended. Start date (EU): 2023-11-07. End date (EU): 2026-07-17. End date: 2026-07-18. Decision date: 2023-10-17. Results received: No. Last updated: 2026-05-04.
Decision dates by country: BE: 2023-10-23, IT: 2023-10-19, GR: 2023-10-18, FR: 2023-10-20, HR: 2023-10-20, BG: 2023-10-23, DE: 2023-10-18, PT: 2023-10-17, HU: 2023-10-20, RO: 2023-10-23, ES: 2023-10-23

Condition(s): Rheumatoid Arthritis
Product: Humira 40 mg solution for injection in pre-filled pen, Humira 40 mg solution for injection in pre-filled pen, Humira 40 mg solution for injection in pre-filled pen, Humira 40 mg solution for injection in pre-filled syringe, Humira 40 mg solution for injection in pre-filled syringe, Upadacitinib, Humira 40 mg solution for injection in pre-filled pen, Humira 40 mg solution for injection in pre-filled syringe, Upadacitinib Placebo, Adalimumab Placebo, Humira 40 mg solution for injection in pre-filled syringe

Primary endpoint: The primary endpoint is achievement of DAS28-CRP ≤ 3.2 at Week 12. DAS28-CRP will be calculated based on the values of TJC28, SJC28, PtGA, and hsCRP.
Endpoint(s): Achievement of ACR50 at Week 12. Achievement of ACR50 response will be determined based on 50% or greater improvement in TJC68 and SJC66 and ≥ 3 of the 5 measures of Patient's Assessment of Pain (past week, NRS), Patient's Global Assessment of Disease Activity (PtGA [past week, NRS]), Physician's Global Assessment of Disease Activity (PhGA [NRS]), HAQ-DI, or hsCRP., Achievement of DAS28-CRP < 2.6 at Week 12, Change from baseline in DAS28-CRP at Week 12, Change from baseline in Patient's Assessment of Pain at Week 12, Change from baseline in HAQ-DI at Week 12

Source: https://euclinicaltrials.eu/ctis-public/view/2022-502578-18-00